EU clinical trial 2023-510422-32-00: A Phase III, Multicentre, Randomised, Double-Blind Study to Assess the Safety and Efficacy of Emactuzumab vs. Placebo in Subjects with Tenosynovial Giant Cell Tumour
Protocol code: SNX-301-020
Sponsor: Synox Therapeutics Limited (Pharmaceutical company). Phase: Therapeutic confirmatory (Phase III). Countries: Belgium (ongoing, recruitment ended), Poland (ended), France (ongoing, recruitment ended), Austria (ended), Spain (ongoing, recruitment ended), Italy (ongoing, recruitment ended), Sweden (ongoing, recruitment ended), Netherlands (ongoing, recruitment ended).
Therapeutic area(s): Diseases [C] - Neoplasms [C04]
Gender: Female, Male. Age: 0-17 years, 18-64 years, 65+ years. Enrolment: 101.
Start date (EU): 2024-09-10. Decision date: 2024-08-20. Results received: No. Last updated: 2026-07-15.
Decision dates by country: PL: 2024-08-26, AT: 2024-08-26, FR: 2024-08-22, SE: 2024-08-22, NL: 2024-08-26, IT: 2024-08-21, BE: 2024-08-20, ES: 2024-08-20

Condition(s): Tenosynovial Giant Cell Tumour
Product: Emactuzumab, Placebo will be presented as a sterile, colourless concentrate of excipients only, buffered at pH 6.0, in a single-use 10 mL vial. The IMP and the placebo are indistinguishable.

Primary endpoint: ORR according to RECIST v1.1 by 6 months from initiation of therapy based on independent, blinded central review
Endpoint(s): Key secondary efficacy endpoint: ORR according to Tumour Volume Score (TVS) at 6 months from initiation of therapy based, Key secondary efficacy endpoint: Change in Patient-Reported Outcomes Measurement Information System -Physical Function Scale (PROMIS-PF) TGCT T-score from baseline to 6 months, Key secondary efficacy endpoint: Change in Physician/Healthcare Professional (HCP)-Reported Joint Mobility Score by goniometry from baseline to 6 months, Key secondary efficacy endpoint: Change in Worst Stiffness Numerical Rating Scale (NRS) from baseline to 6 months, Key secondary efficacy endpoint: Change in Worst Pain NRS from baseline to 6 months, Key secondary efficacy endpoint: Change in EuroQoL 5 Dimension, 5 Level questionnaire (EQ-5D-5L) Visual Analogue Scale (VAS) from baseline to 6 months, Change in PROMIS-PF TGCT T-score from baseline over time, Change in Physician/Healthcare Professional (HCP)-Reported Joint Mobility Score by goniometry from baseline over time, Change in Worst Pain (NRS) from baseline over time, Change in Worst Stiffness NRS from baseline over time (this was previously #6), Change in EQ-5D-5L VAS from baseline over time, Change in EQ-5D-5L 5 dimension scores from baseline over time, Change in Short Form 12-Item Survey version 2 (SF-12 v2) from baseline over time, Changes in PGI severity from baseline over time, PGI-change over time, Duration of response (DoR) as measured by RECIST version 1.1 based on independent, blinded central review, Disease control rate (DCR) at 6 month as per RECIST v1.1 definition based on independent, blinded central review, Time to response (TTR) as measured by RECIST v1.1 based on independent, blinded central review, Time to progression (TTP)as measured by RECIST v1.1 based on independent, blinded central review, Change in (TVS) from baseline over time, Surgical intervention rate, defined as the number of subjects who undergo surgery during the study for TGCT, AES, Deaths, Healthcare utilisation, Ability to work, Serum concentrations of emactuzumab

Source: https://euclinicaltrials.eu/ctis-public/view/2023-510422-32-00